EU clinical trial 2024-513971-42-00: A Randomized Clinical Trial, Multicentre, Open-label, Parallel-group, to define the best Strategy for the management of hEart failure aNd chronic kidney disease among elderly patients with or at high risk of hyperKalemia in spAin by optimizing the use of RAASi with SZC: SENEKA Study
Protocol code: SENEKA
Sponsor: Hospital Clinico Universitario De Valencia (Hospital/Clinic/Other health care facility). Phase: Therapeutic confirmatory (Phase III). Countries: Spain (ongoing, recruiting).
Therapeutic area(s): Diseases [C] - Cardiovascular Diseases [C14]
Gender: Female, Male. Age: 65+ years. Enrolment: 94.
Status: Ongoing, recruiting. Start date (EU): 2024-10-01. Decision date: 2024-08-12. Results received: No. Last updated: 2025-08-27.

Condition(s): Chronic heart failure (NYHA I-III) and non-dialysis CKD
Product: Lokelma 10 g powder for oral suspension, Lokelma 5 g powder for oral suspension

Primary endpoint: Number of patients increasing at least 25% of the target doses of RAASi since the screening visit (V0) to 3 months after study inclusion (V9), considering the target dose of each RAASi drug in the ESC guidelines (1).
Endpoint(s): Number of patients achieving at least 50% of the target doses of RAASi since the screening visit (V0) to 3 months after study inclusion (V9), considering the target dose of each RAASi drug recommended in the ESC guidelines., Number of patients increasing 50% of RAASi doses since the screening visit (0) to 3 months after study inclusion (V9), considering the target dose of each RAASi drug recommended in the ESC guidelines., Number of patients achieving at least 50% of the target doses of MRA since the screening visit (V0) to 3 months after study inclusion (V9), considering the target dose of each MRA drug recommended in the ESC guidelines., Number of patients increasing 50% of MRA doses since the screening visit (V0) to 3 months after study inclusion (V9), considering the target dose of each MRA drug recommended in the ESC guidelines, Number of patients achieving at least 50% of the target doses of MRA and RAASi since the screening visit (0) to 3 months after study inclusion (V9), considering the target dose recommended in the ESC guidelines, Number of patients increasing 50% of MRA and RAASi doses since the screening visit (V0) to 3 months after study inclusion (V9), considering the target dose of each drug recommended in the ESC guidelines, Number of patients achieving the target doses of RAASi since the screening visit (V0) to 3 months after study inclusion (V9), considering the target dose of each RAASi drug recommended in the ESC guidelines, Proportion of patients in each group requiring down titration of RAASi and/or MRA over the study period., Proportion of patients in each group that required up titration of RAASi and/or MRA following down titration of RAASi and/or MRA., Proportion of patients in each group requiring discontinuation of RAASi and/or MRA over the study period., Number of patients achieving at least 50% of the target doses of RAASi since the screening visit (V0) to 1 month after study inclusion, considering the target dose of each RAASi drug recommended in the ESC guidelines, Number of patients increasing 50% of RAASi doses since the screening visit (V0) to 1 month after study inclusion, considering the target dose of each RAASi drug recommended in the ESC guidelines, Number of patients achieving a decrease of at least 5% in NT-proBNP levels since the baseline visit (V1) to 3 months after study inclusion (V9)., Mean Change in NT-proBNP levels since the baseline visit (V1) to 3 months after study inclusion (V9)., Number of patients achieving a decrease of at least 5% in CA125 levels since the baseline visit (V1) to 3 months after study inclusion (V9)., Mean Change in CA125 levels since the baseline visit (V1) to 3 months after study inclusion (V9)., Mean change on Systolic arterial blood pressure measurement from baseline visit (V1) to 3 months after study inclusion (V9)., Mean change from baseline visit (V1) measured at 3 months after study inclusion (V9) in the overall summary score of KKCQ, as a specific HF patient reported outcome questionnaire., To determine the change in renal function the following variables will be calculated between baseline visit (V1) and 3 months after study inclusion (V9): Mean Change in UACR and Mean change in HCO3, Number of patients decreasing at least 40% the eGFR since the screening visit (0) to 3 months after study inclusion (V9)., Mean change from baseline visit (V1) measured at 3 months after study inclusion (V9) (V9) in the overall summary score of KDQoL, as a specific CKD patient reported outcome questionnaire., Number of visits for HF/HK/impaired renal function/hypertension or hyperkalemia diagnosed in the outpatient clinic., Proportion of patients requiring hospitalization for HF/HK/impaired renal function over the study period., Mean number of hospitalizations per patient for HF/HK/impaired renal function over the study period., Proportion of patients presenting at least one clinical event over the study period, Proportion of patients presenting more than one clinical event over the study period, Proportion of patients presenting all clinical events over the study period, Percentage of patients treated with and without sodium-glucose cotransporter-2 (SGLT2) inhibitors over the study period in both arms, Mean Change in Mg levels since the baseline visit (V1) to 3 months after study inclusion (V9).

Source: https://euclinicaltrials.eu/ctis-public/view/2024-513971-42-00